EU clinical trial 2024-516330-35-00: A Phase III, Randomized, Double-Blind, Placebo-Controlled Study of Platinum Plus Pemetrexed Chemotherapy Plus Osimertinib Versus Platinum Plus Pemetrexed Chemotherapy Plus Placebo in Patients with EGFRm, Locally Advanced or Metastatic NSCLC who have Progressed Extracranially following First-Line Osimertinib Therapy (COMPEL)
Protocol code: D5162C00042
Sponsor: AstraZeneca AB (Pharmaceutical company). Phase: Therapeutic confirmatory (Phase III). Countries: Germany (ended), Spain (ongoing, recruitment ended), Italy (ended).
Therapeutic area(s): Diseases [C] - Neoplasms [C04]
Gender: Female, Male. Age: 18-64 years, 65+ years. Enrolment: 155.
Start date (EU): 2021-09-29. Decision date: 2024-09-16. Results received: No. Last updated: 2026-07-07.
Decision dates by country: DE: 2024-09-16, ES: 2024-09-17, IT: 2024-09-17

Condition(s): Non-Small Cell Lung Cancer
Product: Placebo to Osimertinib - Film-coated tablet - 40mg / 80mg, PEMETREXED, TAGRISSO 80 mg film-coated tablets, PEMETREXED, CARBOPLATIN, CISPLATIN, TAGRISSO 40 mg film-coated tablets

Primary endpoint: PFS is defined as time from randomization until progression (intracranial or extracranial, whichever occurs first) per RECIST 1.1 (for extracranial progression) and CNS RECIST 1.1 (for intracranial progression) as assessed by the Investigator at local site or death due to any cause
Endpoint(s): Intracranial PFS is defined as time from randomization until intracranial progression per CNS RECIST 1.1 as assessed by the Investigator at local site or death due to any cause, Extracranial PFS is defined as time from randomization until extracranial progression per RECIST 1.1 as assessed by the Investigator at local site or death due to any cause, OS is defined as the length of time from randomization until the date of death due to any cause

Source: https://euclinicaltrials.eu/ctis-public/view/2024-516330-35-00